EU clinical trial 2023-508693-29-00: Interventional, open-label, single-group, long-term follow-up trial of Lu AG22515 in patients with moderate-to-severe Thyroid Eye Disease
Protocol code: 20453A
Sponsor: H. Lundbeck A/S (Pharmaceutical company). Phase: Human Pharmacology (Phase I)- Other. Countries: Poland (ongoing, recruitment ended), Bulgaria (ongoing, recruitment ended), Germany (ended), Spain (ended).
Therapeutic area(s): Diseases [C] - Immune System Diseases [C20]
Gender: Female, Male. Age: 18-64 years. Enrolment: 19.
Start date (EU): 2024-09-19. Decision date: 2024-08-06. Results received: No. Last updated: 2025-12-18.
Decision dates by country: DE: 2025-05-22, BG: 2024-08-07, PL: 2024-08-06, ES: 2025-06-12

Condition(s): Active, moderate-to-severe TED

Primary endpoint: TED Proptosis 1. Primary endpoints: Change in proptosis from Baseline to Week 24 in the trial eye using the Hertel exophthalmometer
Endpoint(s): Pharmacokinetics 1. Secondary endpoints: - exposure to Lu AG22515 as observed: Cmax, tmax, Ctrough - exposure to Lu AG22515 as modelled: AUC, CL, V, and t½; Safety 1. TEAEs 2. changes from Baseline in clinical safety laboratory test values, vital signs, weight, and ECG parameter values 3. PCS clinical safety laboratory test values, vital signs, weight changes, and ECG parameter values; Immunogenicity 1. presence of anti-Lu AG22515 antibodies (ADAs)

Source: https://euclinicaltrials.eu/ctis-public/view/2023-508693-29-00